EU clinical trial 2024-514212-27-00: Hydralazine-ISDN in Patients With Chronic Heart Failure - Hydralazine Heart Failure Trial (H-HeFT) Metformin in Patients with Chronic Heart Failure and Diabetes or Insulin Resistance - Metformin Heart Failure Trial (Met-HeFT) A randomized, 2 x 2 factorial designed, double-blind, placebo controlled study (DANHEART).
Protocol code: DANHEART
Sponsor: Aarhus Universitetshospital (Health care). Phase: Therapeutic confirmatory (Phase III). Countries: Denmark (ended).
Therapeutic area(s): Diseases [C] - Cardiovascular Diseases [C14]
Gender: Female, Male. Age: 18-64 years, 65+ years. Enrolment: 1500.
Status: Ended. End date (EU): 2026-02-18. Decision date: 2024-09-10. Results received: No. Last updated: 2025-11-28.

Condition(s): Heart failure
Product: BiDil, Placebo (to Hydralazine / Isosorbide dinitrate), Placebo (To Metformin hydrochloride), METFORMIN HYDROCHLORIDE

Primary endpoint: H-HeFT: Death or hospitalization with worsening heart failure or an urgent visit resulting in intravenous therapy or metolazone therapy for heart failure or heart transplantation or implantation of a left ventricular assist device (LVAD)., Met-HeFT: A composite of total (first and recurrent) events in the primary endpoint: Death or hospitalization with worsening heart failure or an urgent visit resulting in intravenous therapy or metolazone therapy for heart failure or heart transplantation or implantation of a LVAD or acute myocardial infarction or stroke
Endpoint(s): H-HeFT: 1. Individual components of the primary endpoint, H-HeFT: 2. Combined endpoint: Death or cardiovascular hospitalizations (hospitalization with worsening heart failure or heart transplantation or implantation of a left ventricular assist device (LVAD) or acute myocardial infarction or stroke or acute myocardial infarction or stroke), Met-HeFT: 1. Extended clinical endpoint: The primary endpoint or coronary revascularization or non-coronary revascularization or limb amputation., Met-HeFT: 2. New diagnosis of diabetes mellitus, Met-HeFT: 3. Hospitalization/ death due to lactate acidosis, Met-HeFT: 4. Individual components of the primary endpoint, H-HeFT: Change in NT-proBNP from baseline to final follow-up, Met-HeFT: Change in NT-proBNP from baseline to final follow-up, Met-HeFT: Combined endpoint, first event: Death or hospitalization with worsening heart failure or an urgent visit resulting in intravenous therapy or metolazone therapy for heart failure or heart transplantation or implantation of a LVAD or acute myocardial infarction or stroke, Met-HeFT: Total hospitalizations

Source: https://euclinicaltrials.eu/ctis-public/view/2024-514212-27-00